EU clinical trial 2023-506975-83-00: APRILIAH (Aprogen Phase III Clinical Trial to Compare Efficacy, Safety, and Immunogenicity of AP063 in Subjects with HER2+ Breast Cancer)
Protocol code: AP063-003
Sponsor: Aprogen Inc. (Pharmaceutical company). Phase: Therapeutic confirmatory (Phase III). Countries: Poland (ended), Romania (ended).
Therapeutic area(s): Diseases [C] - Neoplasms [C04]
Gender: Female. Age: 18-64 years, 65+ years. Enrolment: 66.
Status: Ended. End date (EU): 2025-04-17. End date: 2025-04-18. Decision date: 2024-03-08. Results received: No. Last updated: 2024-07-01.
Decision dates by country: PL: 2024-03-08, RO: 2024-03-11

Condition(s): HER2-positive metastatic breast cancer (MBC) and early breast cancer (EBC)

Source: https://euclinicaltrials.eu/ctis-public/view/2023-506975-83-00